EU clinical trial 2024-519205-35-01: Neoadjuvant chemo-immunotherapy for stage III PD-L1 positive Non-Small Cell Lung Cancer (NSCLC)
Protocol code: CHALLENGE
Sponsor: Fondazione Ricerca Traslazionale (Laboratory/Research/Testing facility). Phase: Therapeutic exploratory (Phase II). Countries: Italy (ongoing, recruiting).
Therapeutic area(s): Diseases [C] - Neoplasms [C04]
Gender: Female, Male. Age: 18-64 years, 65+ years. Enrolment: 30.
Status: Ongoing, recruiting. Start date (EU): 2025-07-08. Decision date: 2025-03-27. Results received: No. Last updated: 2026-07-30.

Condition(s): stage III PD-L1 positive Non-Small Cell Lung Cancer (NSCLC)
Product: Tevimbra 100 mg concentrate for solution for infusion, Paclitaxel Accord Healthcare Italia 6 mg/ml, concentrato per soluzione per infusione, Pemetrexed Ever Pharma 25 mg/ml concentrato per soluzione per infusione, Carboplatino Hikma 10 mg/ml soluzione per infusione, Cisplatino Hikma 1mg/ml concentrato per soluzione per infusione

Primary endpoint: Complete tumor resection rate (R0). An R0 resection means that the surgical margin is microscopically negative for residual tumor.
Endpoint(s): Percentage of nodal downstaging defined as following neoadjuvant chemoimmunotherapy, Pathological complete response (pCR) and major pathological response (MPR). pCR means 0% residual viable tumor cells in the primary tumor and sampled lymph nodes; MPR means ≤10% residual viable tumor cells in the primary tumor and sampled lymph nodes., Event-free survival (EFS) was defined as the time from study enrollment to any progression of disease before local treatment (surgery or radiotherapy) or recurrence of disease after local treatment (surgery or radiotherapy), progression of disease in the absence of surgery, or death from any cause., Overall survival (OS) was defined as the time from study enrollment to death of any cause

Source: https://euclinicaltrials.eu/ctis-public/view/2024-519205-35-01